EU clinical trial 2024-513412-10-00: A Phase I/II study of Brigatinib in pediatric and young adult patients with ALK+ Anaplastic Large Cell Lymphoma, Inflammatory Myofibroblastic Tumors or other solid tumors
Protocol code: BrigaPED ITCC-098
Sponsor: Prinses Maxima Centrum voor Kinderoncologie B.V. (Hospital/Clinic/Other health care facility). Phase: Phase I and Phase II (Integrated)- Other. Countries: Netherlands (ongoing, recruiting), Czechia (ongoing, recruiting), France (ongoing, recruiting), Sweden (ongoing, recruiting), Austria (authorised, recruiting), Germany (ongoing, recruiting), Italy (authorised, recruiting), Finland (ongoing, recruiting), Belgium (ongoing, recruiting), Denmark (authorised, recruiting), Spain (ongoing, recruiting), Poland (authorised, recruitment pending), Norway (authorised, recruitment pending).
Therapeutic area(s): Diseases [C] - Neoplasms [C04]
Gender: Female, Male. Age: 0-17 years, 18-64 years. Enrolment: 57.
Start date (EU): 2022-05-11. Decision date: 2024-10-31. Results received: No. Last updated: 2026-07-10.
Decision dates by country: FR: 2024-11-05, DK: 2024-11-04, NL: 2024-10-31, BE: 2024-11-04, DE: 2024-11-07, IT: 2024-11-11, ES: 2024-11-12, CZ: 2024-11-05, PL: 2024-11-07, FI: 2024-11-01, AT: 2024-11-05, NO: 2026-07-10, SE: 2024-10-31

Condition(s): Anaplastic Large Cell Lymphoma (ALCL), Inflammatory Myofibroblastic Tumors (IMT), Other solid tumors
Product: BRIGATINIB, Alunbrig 180 mg film-coated tablets, Alunbrig 90 mg film-coated tablets, Alunbrig 30 mg film-coated tablets

Primary endpoint: Phase 1: dose-limiting toxicities (DLTs) during the first course of therapy., Phase 1: Brigatinib plasma PK parameters to be determined: o maximum observed concentration (Cmax), o time of first occurrence of maximum observed concentration (Tmax), o area under the concentration-time curve from time 0 to the time of the last quantifiable concentration (AUClast)., Phase 1: The RP2D will be selected by the DSMB and will be based on the dose that results in equivalent (approximately ±20% of the adult values) PK exposure to the adult comparator and with <2 out of 6 patients at this dose level present with a DLT and taking into account responses observed in phase 1., Cohort B1: Overall response rate (ORR), defined as the percentage of patients with CR or PR according to RECIST 1.1 after 1 course and best ORR during brigatinib treatment., Cohort B2: EFS (using the IPNHL response criteria), defined as the time between start of study treatment and first event being progressive disease, relapse, death of any cause and second malignancies, whatever happens first. Patients consolidated with HSCT will be censored., Cohort B1R: Overall response rate (ORR), defined as the percentage of patients with CR or PR according to RECIST 1.1 after 1 course and best ORR during brigatinib re-treatment., Cohort B2R: EFS (using the IPNHL response criteria), defined as the time between restart of study treatment and first event being progressive disease, relapse, death of any cause and second malignancies, whatever happens first. Patients consolidated with HSCT will be censored.

Source: https://euclinicaltrials.eu/ctis-public/view/2024-513412-10-00